EU clinical trial 2024-519513-61-00: Phase IV, single-center, double blind, randomized, crossover, placebo-controlled study, to investigate the effect of dual bronchodilation with umeclidinium/vilanterol on patients with COPD, hyperinflation and heart failure
Protocol code: CHHEF
Sponsor: Hospital General Universitario Gregorio Maranon (Hospital/Clinic/Other health care facility). Phase: Therapeutic use (Phase IV). Countries: Spain (ongoing, recruiting).
Therapeutic area(s): Diseases [C] - Respiratory Tract Diseases [C08]
Gender: Female, Male. Age: 18-64 years, 65+ years. Enrolment: 60.
Status: Ongoing, recruiting. Start date (EU): 2024-11-20. Decision date: 2024-11-20. Results received: No. Last updated: 2024-11-20.

Condition(s): Chronic obstructive pulmonary diseases with Heart Failure with eyection ventricular ejection fraction between 35-50%
Product: ANORO ELLIPTA 55 micrograms/22 micrograms inhalation powder, pre-dispensed, Placebo Ellipta, Flixotide 250 microgramos/inhalación, suspensión para inhalación en envase a presión, Ventolin 100 microgramos/inhalación suspensión para inhalación en envase a presión* (*) sin CFC

Primary endpoint: Baseline-corrected, time-velocity integral (a direct surrogate of SV) during peak exercise, as measured by exercise Doppler-echocardiography (last satisfactory measurement), Maximal oxygen pulse on a cardiopulmonary exercise test on cycle-ergometer
Endpoint(s): Resting lung volumes ( Inspiratory capacity, functional residual capacity and residual volume), Inspiratory Capacity every 2 minutes during the incremental exercise test, Left and right cardiac chambers volumes at rest in patients, as measured by MRI, Baseline-corrected peak ejection intraventricular pressure difference (peak EIVPD) at peak exercise, as measured by exercise color-Doppler M-mode echocardiography (last satisfactory measurement), Pulmonary acceleration time in the main pulmonary artery as measured by phase-contrast MRI, Baseline-corrected peak intraventricular diastolic pressure gradient (peak DIVPD) at peak exercise – diastolic suction, as measured by exercise color-Doppler M-mode echocardiography (last satisfactory measurement), ProBNP levels, Average changes in COPD Assessment Test (CAT) and Transition dyspnea index, Proportion of patients with Clinically relevant changes in COPD Assessment Test (CAT) and Transition dyspnea index ( -4 and -2 respectively)

Source: https://euclinicaltrials.eu/ctis-public/view/2024-519513-61-00